EU clinical trial 2023-503517-30-00: A Phase 3, Randomized, Double-Blind Study of MK-7684A in Combination with Etoposide and Platinum Followed by MK-7684A vs Atezolizumab in Combination with Etoposide and Platinum Followed by Atezolizumab for the First-Line Treatment of Participants with Extensive-Stage Small Cell Lung Cancer (KEYVIBE-008)
Protocol code: MK-7684A-008
Sponsor: Merck Sharp & Dohme LLC (Pharmaceutical company). Phase: Therapeutic confirmatory (Phase III). Countries: Netherlands (ended), Spain (ongoing, recruitment ended), Hungary (ended), Finland (ended), Romania (ongoing, recruitment ended), Italy (ended), Germany (ended), Portugal (ended), Lithuania (ongoing, recruitment ended), Ireland (ended), Austria (ended), France (ended), Greece (ended), Poland (ended).
Therapeutic area(s): Diseases [C] - Neoplasms [C04]
Gender: Female, Male. Age: 18-64 years, 65+ years. Enrolment: 256.
Start date (EU): 2022-04-01. Decision date: 2023-08-22. Results received: No. Last updated: 2026-05-13.
Decision dates by country: IE: 2023-09-05, FR: 2023-09-29, HU: 2023-08-23, AT: 2023-10-04, PT: 2023-09-06, FI: 2023-08-28, LT: 2023-09-12, RO: 2023-09-11, DE: 2023-08-29, GR: 2023-09-29, PL: 2023-11-03, IT: 2023-09-06, NL: 2023-08-22, ES: 2023-08-22

Condition(s): Extensive-stage small-cell lung cancer
Product: ETOPOSIDE, Saline Placebo, MK-7684A, CARBOPLATIN, ATEZOLIZUMAB, CISPLATIN

Primary endpoint: Overall Survival (OS)
Endpoint(s): Progression-Free Survival (PFS), Objective Response Rate (ORR), Duration of Response (DOR), Percentage of Participants Who Experienced an Adverse Event (AE), Percentage of Participants Who Discontinued Study Treatment Due to an AE, Change from Baseline in the Global Health Status/Quality of Life (Items 29 and 30) Combined Score on the European Organization for Research and Treatment of Cancer Quality of Life Questionnaire Core 30 (EORTC QLQ-C30), Change from Baseline in Physical Functioning (Items 1-5) Combined Score on the EORTC QLQ-C30, Change from Baseline in Dyspnea Score (Item 8) on the EORTC QLQ-C30, Change from Baseline in Cough Score (Item 31) on the European Organization for Research and Treatment of Cancer Quality of Life Questionnaire Lung Cancer 13 (EORTC QLQ-LC13), Change from Baseline in Chest Pain Score (Item 40) on the EORTC QLQ-LC13, Time to True Deterioration (TTD) in the Global Health Status/Quality of Life (Items 29 and 30) Combined Score on the EORTC QLQ-C30, TTD in Physical Functioning (Items 1-5) Combined Score on the EORTC QLQ-C30, TTD in Dyspnea Score (Item 8) on the EORTC QLQ-C30, TTD in Cough Score (Item 31) on the EORTC QLQ-LC13, TTD in Chest Pain Score (Item 40) on the EORTC QLQ-LC13

Source: https://euclinicaltrials.eu/ctis-public/view/2023-503517-30-00